EU clinical trial 2023-510370-14-00: A Randomized, Double-Blind, Placebo-Controlled Phase IIa Trial to Evaluate Safety, Pharmacokinetics and Pharmacodynamics of Repeated Subcutaneously Administered RBD4059 in Participants with Stable Coronary Artery Disease
Protocol code: RC03T001
Sponsor: Ribocure Pharmaceuticals AB (Pharmaceutical company). Phase: Therapeutic exploratory (Phase II). Countries: Sweden (ended).
Therapeutic area(s): Diseases [C] - Cardiovascular Diseases [C14]
Gender: Female, Male. Age: 18-64 years, 65+ years. Enrolment: 30.
Status: Ended. Start date (EU): 2024-08-28. End date (EU): 2026-04-29. Decision date: 2024-05-27. Results received: No. Last updated: 2025-12-12.

Condition(s): Stable Coronary Artery Disease
Product: RBD4059 injection, Trombyl 75 mg tabletter, The corresponding placebo consist of the 25 mM phosphate buffer solution with 2 µg of vitamin b2 added for colouring purposes only

Primary endpoint: Frequency, intensity and seriousness of the AEs during the trial as well as clinically significant changes in laboratory parameters, vital signs, physical examinations and 12-lead ECG at each visit from baseline to end of trial.
Endpoint(s): Plasma concentrations of RBD4059 will be summarised with descriptive statistics by sampling collection time point, Actual and percentage change from baseline in FXI activity and compared to placebo throughout the trial period, Proportion of participants with positive immunogenicity, measured as titers of anti-drug antibodies (ADAs), at each evaluation time point., Change from baseline in APTT and PK(INR) levels compared to placebo throughout the trial period, Change from baseline in platelet inhibition levels compared to placebo throughout the trial period.

Source: https://euclinicaltrials.eu/ctis-public/view/2023-510370-14-00